EU clinical trial 2023-504670-38-00: IFCT-2203 TAXIO A phase II study assessing the efficacy of etoposide free chemotherapy plus durvalumab (MEDI4736) in first line extensive disease Small Cell Lung Cancer (SCLC)
Protocol code: IFCT-2203 TAXIO
Sponsor: Intergroupe Francophone de Cancerologie Thoracique (Pharmaceutical company). Phase: Therapeutic exploratory (Phase II). Countries: France (ongoing, recruitment ended), Luxembourg (not authorised).
Therapeutic area(s): Diseases [C] - Neoplasms [C04]
Gender: Female, Male. Age: 18-64 years, 65+ years. Enrolment: 72.
Start date (EU): 2023-11-17. Decision date: 2023-08-23. Results received: No. Last updated: 2025-03-27.
Decision dates by country: LU: 2023-08-25, FR: 2023-08-23

Condition(s): Extensive disease Small Cell Lung Cancer
Product: IMFINZI 50 mg/mL concentrate for solution for infusion., CARBOPLATIN, PACLITAXEL

Primary endpoint: Overall Survival (OS) rate at 12 months
Endpoint(s): Best response rate (RECIST 1.1) which is defined as the percentage of subjects with a complete response (CR) or partial response (PR) determined by Investigator review and by independent reviewer as per RECIST v1.1 criteria, Overall Survival (OS) defined as the time from the date of first dose of study drug to the date of death due to any cause, Overall Survival (OS) at 24 months and at 36 months, Progression free survival (PFS) defined as the time from the date of first dose of study drug to the earliest date of disease progression, as determined by Investigator review and by independent reviewer of radiographic disease assessments per RECIST v1.1, or death due to any cause, Duration of response (DOR) defined as the time from the date of the best documented response (CR or PR) to the earliest date of disease progression, as determined by Investigator review and by independent reviewer of radiographic disease assessments per RECIST v1.1, or death due to any cause, Incidence, nature, and severity of adverse events, graded according to the National Cancer Institute Common Terminology Criteria for Adverse Events, Version 5.0 (NCI CTCAE v5.0), Change from baseline of Quality of life assessment using European Organization for Research and Treatment of Cancer Quality of Life Questionnaire-Core 30 (EORTC QLQ-C30 LC13)at all scheduled time points.

Source: https://euclinicaltrials.eu/ctis-public/view/2023-504670-38-00